EU clinical trial 2023-504346-66-00: A multinational, multicenter, double-blind, placebo-controlled phase 2 study to evaluate efficacy and safety of SAR444656 in adult participants with moderate to severe atopic dermatitis.
Protocol code: ACT17754
Sponsor: Sanofi-Aventis Recherche & Developpement (Pharmaceutical company). Phase: Therapeutic exploratory (Phase II). Countries: Germany (ended), Poland (ended), Greece (ended), Czechia (ended).
Therapeutic area(s): Diseases [C] - Skin and Connective Tissue Diseases [C17]
Gender: Female, Male. Age: 18-64 years, 65+ years. Enrolment: 180.
Status: Ended. Start date (EU): 2024-02-14. End date (EU): 2025-11-20. End date: 2025-11-21. Decision date: 2023-12-19. Results received: No. Last updated: 2025-12-02.
Decision dates by country: CZ: 2025-04-15, DE: 2023-12-19, GR: 2023-12-22, PL: 2024-01-10

Condition(s): Dermatitis atopic
Product: Matched, SAR444656

Primary endpoint: Percent change from baseline in EASI.
Endpoint(s): Proportion of participants with validated Investigational Global Assessment (vIGA)-AD of 0 or 1 and a reduction from baseline of ≥2 points, Proportion of participants achieving EASI-75 (reduction of EASI score by ≥75% from baseline)., Absolute change from baseline in EASI., Proportion of participants achieving EASI-50 (reduction of EASI score by ≥50% from baseline)., Proportion of participants achieving EASI-90 (reduction of EASI score by ≥90% from baseline)., Change from baseline in percent body surface area (BSA) affected by AD, Proportion of participants with reduction of weekly average of daily peak pruritus numeric rating scale (PP-NRS) by ≥4 points from baseline, Percent change from baseline in weekly average of daily PP-NRS., Absolute change from baseline in weekly average of daily PP-NRS., Incidence of treatment-emergent adverse events (TEAEs), serious adverse events (SAEs), and adverse events of special interest (AESIs), investigational medicinal product (IMP) discontinuation due to TEAEs, Plasma SAR444656 concentration.

Source: https://euclinicaltrials.eu/ctis-public/view/2023-504346-66-00